EU clinical trial 2024-516563-86-00: A Placebo-controlled Study to Evaluate the Efficacy and Safety of Clenbuterol in Patients with Spinal and Bulbar Muscular Atrophy (SBMA)
Sponsor: Azienda Ospedaliera di Padova (Hospital/Clinic/Other health care facility). Phase: Therapeutic exploratory (Phase II). Countries: Italy (ongoing, recruitment ended).
Therapeutic area(s): Diseases [C] - Nervous System Diseases [C10]
Gender: Male. Age: 18-64 years, 65+ years. Enrolment: 90.
Status: Ongoing, recruitment ended. Start date (EU): 2024-04-11. Decision date: 2024-09-16. Results received: No. Last updated: 2026-06-05.

Condition(s): Spinal and Bulbar Muscular Atrophy
Product: Monores® 20 microgrammi Compresse, placebo

Primary endpoint: A responder to the assigned treatment (clenbuterol or placebo) will be defined as a subject with a 15% increase at V7 (48 weeks), compared to baseline, in the distance covered in six minutes at the 6MWT. The primary endpoint will be the percentage of responders in the two treatment arms.
Endpoint(s): 6MWT during the 48-weeks treatment period (from V2 to V7) in the two treatment arms, SBMA-FRS total score during the 48-weeks treatment period (from V2 to V7) in the two treatment arms, AMAT total score during the 48-weeks treatment period (from V2 to V7) in the two treatment arms, FVC during the 48-weeks treatment period (from V2 to V7) in the two treatment arms, 6K total score during the 48-weeks treatment period (from V2 to V7) in the two treatment arms, serum creatinine levels during the 48-weeks treatment period (from V2 to V7) in the two treatment arms, ALSAQ-40 total score during the 48-weeks treatment period (from V2 to V7) in the two treatment arms, INQOL total score during the 48-weeks treatment period (from V2 to V7) in the two treatment arms

Source: https://euclinicaltrials.eu/ctis-public/view/2024-516563-86-00